EU clinical trial 2024-516589-13-00: "MetCool ACS"- Metformin "Cooling" Effect on metformin-naive Patients Treated with PCI because of Acute Coronary Syndrome
Protocol code: MC-ACS01-2020
Sponsor: Wojskowy Instytut Medyczny Panstwowy Instytut Badawczy (Hospital/Clinic/Other health care facility). Phase: Therapeutic confirmatory (Phase III). Countries: Poland (authorised, recruitment pending).
Therapeutic area(s): Diseases [C] - Cardiovascular Diseases [C14]
Gender: Female, Male. Age: 18-64 years, 65+ years. Enrolment: 1000.
Status: Authorised, recruitment pending. Decision date: 2024-11-18. Results received: No. Last updated: 2026-07-20.

Condition(s): Acute coronary syndrome
Product: METFORMIN HYDROCHLORIDE, METFORMIN HYDROCHLORIDE

Primary endpoint: The need to perform unplanned PCI or CABG after successful last stage of full revascularization because of ACS
Endpoint(s): Cardiac death after successful final stage of revascularization due to ACS in the 30-month follow-up period, Death from any cause after successful final stage of revascularization due to ACS in the 30-month follow-up period, Non-fatal myocardial infarction after successful final stage of revascularization due to ACS in the 30-month follow-up period, Non-fatal stroke after successful final stage of revascularization due to ACS in the 30-month follow-up period

Source: https://euclinicaltrials.eu/ctis-public/view/2024-516589-13-00